EU clinical trial 2025-524095-27-00: A Phase 2, Open-Label, Multicenter, Randomized Study to Evaluate Denikitug as Monotherapy or in Combination With Nivolumab or Chemotherapy in Participants With HER2-Negative, Unresectable, Recurrent, and/or Metastatic Gastric, Gastroesophageal Junction (GEJ), and Esophageal Adenocarcinomas
Protocol code: GS-US-742-7757
Sponsor: Gilead Sciences Inc. (Pharmaceutical company). Phase: Therapeutic exploratory (Phase II). Countries: Spain (authorised, recruitment pending), France (authorised, recruitment pending).
Therapeutic area(s): Diseases [C] - Neoplasms [C04]
Gender: Female, Male. Age: 18-64 years, 65+ years. Enrolment: 45.
Status: Authorised, recruitment pending. Decision date: 2026-06-11. Results received: No. Last updated: 2026-07-01.
Decision dates by country: FR: 2026-06-16, ES: 2026-06-11

Condition(s): HER2-negative, unresectable, recurrent, and/or metastatic gastric, GEJ, and esophageal adenocarcinomas
Product: OPDIVO 10 mg/mL concentrate for solution for infusion., Abraxane 5 mg/ml powder for dispersion for infusion., OPDIVO 10 mg/mL concentrate for solution for infusion., GS-1811 , OPDIVO 10 mg/mL concentrate for solution for infusion., Cyramza 10 mg/ml concentrate for solution for infusion, GS-1811 150 mg/vial concentrate for solution for infusion, OPDIVO 10 mg/mL concentrate for solution for infusion.

Primary endpoint: ORR is defined as the percentage of participants who have achieved complete response (CR) or partial response (PR) as assessed by the investigator according to RECIST Version 1.1.
Endpoint(s): DOR is measured from the time of first response (CR or PR) as assessed by investigator, per RECIST Version 1.1 until the date of first documented progressive disease (PD) or death, whichever comes first., PFS is the time from date of first dose until PD or death from any cause, whichever comes first as assessed by the investigator according to RECIST Version 1.1., OS is length of time from first dose until the date of death from any cause., The incidence, severity, seriousness, and relatedness of treatment-emergent adverse events (TEAEs) and incidence and severity of clinical laboratory abnormalities graded according to National Cancer Institute (NCI)-Common Terminology Criteria for Adverse Events (CTCAE) Version 5.0., Serum concentration of DEN and estimated PK parameters (eg, Cmax, AUCall)., Percentage of treatment-emergent antidrug (DEN) antibody (ADA)-positive and ADA-negative participants.

Source: https://euclinicaltrials.eu/ctis-public/view/2025-524095-27-00